EU clinical trial 2023-503965-48-00: DS-1103a Combination Therapy First-in-human (FIH) Study
Protocol code: DS1103-074
Sponsor: Daiichi Sankyo Inc. (Pharmaceutical company). Phase: Human Pharmacology (Phase I)- First administration to humans. Countries: Spain (ongoing, recruiting), France (ongoing, recruiting), Belgium (authorised, recruitment pending).
Therapeutic area(s): Diseases [C] - Neoplasms [C04]
Gender: Female, Male. Age: 18-64 years, 65+ years. Enrolment: 34.
Start date (EU): 2024-01-11. Decision date: 2023-10-05. Results received: No. Last updated: 2026-07-31.
Decision dates by country: FR: 2023-10-11, ES: 2023-10-05, BE: 2024-08-20

Condition(s): Advanced (unresectable or metastatic) human epidermal growth receptor 2 (HER2)-expressing/HER2-mutated solid tumors

Source: https://euclinicaltrials.eu/ctis-public/view/2023-503965-48-00